EU clinical trial 2024-515338-34-01: Biomarkers in clozapine-responding schizophrenia
Protocol code: BICS2019
Sponsor: Region Hovedstaden (Hospital/Clinic/Other health care facility). Phase: Therapeutic use (Phase IV). Countries: Denmark (ongoing, recruiting).
Therapeutic area(s): Diseases [C] - Nervous System Diseases [C10]
Gender: Female, Male. Age: 18-64 years. Enrolment: 200.
Status: Ongoing, recruiting. Start date (EU): 2024-10-10. Decision date: 2024-10-23. Results received: No. Last updated: 2025-10-01.

Condition(s): Schizophrenia
Product: CLOZAPINE

Primary endpoint: Permeability of the blood-brain barrier blood and CSF inflammatory cytokines

Source: https://euclinicaltrials.eu/ctis-public/view/2024-515338-34-01